EU clinical trial 2024-518954-18-01: Efficacy of botulinum toxin vs corticosteroid in the management of persistent post-surgical scar pain
Sponsor: Mater Misericordiae University Hospital (Hospital/Clinic/Other health care facility). Phase: Therapeutic use (Phase IV). Countries: Ireland (temporarily halted).
Therapeutic area(s): Analytical, Diagnostic and Therapeutic Techniques and Equipment [E] - Anesthesia and Analgesia [E03]
Gender: Female, Male. Age: 18-64 years, 65+ years. Enrolment: 60.
Status: Temporarily halted. Start date (EU): 2024-12-05. Decision date: 2024-12-05. Results received: No. Last updated: 2024-12-05.

Condition(s): Post-surgical scar pain
Product: Bupivacaine 2.5mg/ml Solution for Injection, BOTOX 100 Allergan Units Powder for Solution for Injection, Adcortyl™ Intra-articular / Intradermal Injection 10 mg/ml, Suspension for Injection, 5 ml

Primary endpoint: Numerical rating scale of pain (NRS)
Endpoint(s): b. Brief pain inventory score (short form) (BPI-sf) c. Pain self-efficacy questionnaire (PSEQ) d. Documentation of any adverse events e. Patients global impression of change (PGIC)

Source: https://euclinicaltrials.eu/ctis-public/view/2024-518954-18-01